EU clinical trial 2025-520584-41-00: A study to see how a single increasing dose of the oral drug AD-700 affects the ability of a CT scan to detect activated brown fat in healthy people
Protocol code: IBT-002
Sponsor: Adiposs S.A. (Pharmaceutical company). Phase: Human Pharmacology (Phase I)- Other. Countries: Finland (ongoing, recruitment ended).
Therapeutic area(s): Analytical, Diagnostic and Therapeutic Techniques and Equipment [E] - Diagnosis [E01]
Gender: Male. Age: 18-64 years. Enrolment: 21.
Status: Ongoing, recruitment ended. Start date (EU): 2026-03-10. Decision date: 2025-05-05. Results received: No. Last updated: 2026-03-12.

Condition(s): Metabolism dysfunction

Source: https://euclinicaltrials.eu/ctis-public/view/2025-520584-41-00